EU clinical trial 2024-518631-11-00: Selective serotonin reuptake inhibition in patients with advanced gastroesophageal cancer receiving immunochemotherapy: a prospective phase II trial
Protocol code: Sign
Sponsor: Medical University Of Vienna (Educational Institution). Phase: Therapeutic exploratory (Phase II). Countries: Austria (authorised, recruiting).
Therapeutic area(s): Diseases [C] - Neoplasms [C04]
Gender: Female, Male. Age: 18-64 years, 65+ years. Enrolment: 35.
Status: Authorised, recruiting. Start date (EU): 2023-04-25. Decision date: 2024-12-11. Results received: No. Last updated: 2024-12-11.

Condition(s): gastroesophageal cancer
Product: Sertralin ratiopharm 50 mg Filmtabletten

Primary endpoint: The primary endpoint of this study is the rate of best responses per any timepoint during study period after administration of at least one cycle of immunochemotherapy defined as CR and PR according to RECIST 1.1 criteria
Endpoint(s): • Progression-free survival • Overall survival • Toxicity • Quality of life analyses • Depression scale analyses

Source: https://euclinicaltrials.eu/ctis-public/view/2024-518631-11-00